EU clinical trial 2024-511755-18-00: A Phase 3, Multicenter, Prospective, Randomized, Double-blind Study of Two Treatment Regimens for Candidemia and/or Invasive Candidiasis: Intravenous Echinocandin followed by Oral Ibrexafungerp versus Intravenous Echinocandin followed by Oral Fluconazole (MARIO)
Protocol code: SCY-078-302
Sponsor: Scynexis Inc. (Pharmaceutical company). Phase: Therapeutic confirmatory (Phase III). Countries: Germany (ended), Spain (ended), Bulgaria (ended), Belgium (ended), France (ended), Greece (ended), Italy (ended).
Therapeutic area(s): Diseases [C] - Bacterial Infections and Mycoses [C01]
Gender: Female, Male. Age: 18-64 years, 65+ years. Enrolment: 72.
Status: Ended. Start date (EU): 2022-12-23. End date (EU): 2025-10-14. End date: 2025-12-16. Decision date: 2024-06-19. Results received: Yes. Last updated: 2025-09-16.
Decision dates by country: GR: 2024-07-22, FR: 2024-07-10, IT: 2024-06-25, BG: 2024-07-01, ES: 2024-06-24, BE: 2024-06-21, DE: 2024-06-19

Condition(s): Invasive Candidiasis/ Candidemia
Product: Placebo for ibrexafungerp 250 mg (tablet), Ibrexafungerp, Fluconazole TEVA 200 mg harde capsules, MICAFUNGIN, VORICONAZOLE, ANIDULAFUNGIN, FLUCONAZOLE, CASPOFUNGIN, Fluconazol-GRY 200 mg Hartkapseln, Placebo for fluconazole 200 mg (capsule)

Primary endpoint: All-cause Mortality (ACM) at Day 30 in the ITT population. The percentage of subjects with Successful Global Response, as determined by the DRC at EOT (European Union [EU] only).
Endpoint(s): Key secondary endpoint: The percentage of subjects with Successful Global Response, as determined by the DRC (based on clinical response as determined by the PI, mycological response and radiological response [when applicable]) at Day 14., Efficacy Endpoints: The percentage of subjects with Successful Global Response at Day 30 and EOT as determined by the PI and the DRC., Efficacy Endpoints: The percentage of subjects with Successful Clinical Response at Day 14, Day 30 and EOT as determined by the PI and the DRC., Efficacy Endpoints: The percentage of subjects with Successful Mycological Response at Day 14, Day 30 and EOT as determined by the DRC., Efficacy Endpoints: The percentage of subjects with no recurrence at 2 weeks and 6 weeks after EOT as determined by the DRC., Efficacy Endpoints: The percentage of subjects alive with Successful Global Response at EOT and no recurrence at 6 weeks after EOT as determined by the DRC., Safety Endpoints: Frequency of treatment-emergent adverse events (TEAEs), drug-related adverse events, discontinuations due to AEs, serious adverse events (SAEs), and safety laboratory assessments., PK Endpoint: Description of ibrexafungerp plasma concentrations.

Source: https://euclinicaltrials.eu/ctis-public/view/2024-511755-18-00